EU clinical trial 2022-500101-41-00: A Phase 4, Randomized, Open-Label, Active-Controlled Study to Investigate the Efficacy and Safety of Switching From Weekly Dulaglutide to Weekly Tirzepatide in Adults With Type 2 Diabetes
Protocol code: I8F-MC-GPIH
Sponsor: Eli Lilly Cork Limited (Pharmaceutical company). Phase: Therapeutic use (Phase IV). Countries: Romania (ended), Germany (ended), Belgium (ended), France (not authorised).
Therapeutic area(s): Diseases [C] - Hormonal diseases [C19]
Gender: Female, Male. Age: 18-64 years, 65+ years. Enrolment: 145.
Status: Ended. Start date (EU): 2023-06-07. End date (EU): 2024-07-23. End date: 2024-08-12. Decision date: 2023-02-14. Results received: Yes. Last updated: 2024-08-05.
Decision dates by country: FR: 2023-02-20, DE: 2023-02-15, BE: 2023-02-14, RO: 2023-04-04

Condition(s): Type 2 Diabetes
Product: PIOGLITAZONE, CANAGLIFLOZIN, GLUCAGON, LOPERAMIDE, CANAGLIFLOZIN, COLESEVELAM, DULAGLUTIDE, METFORMIN, EMPAGLIFLOZIN, DULAGLUTIDE, ERTUGLIFLOZIN, DAPAGLIFLOZIN, EMPAGLIFLOZIN, BROMOCRIPTINE, DAPAGLIFLOZIN, DULAGLUTIDE, Tirzepatide, ONDANSETRON, DULAGLUTIDE, ERTUGLIFLOZIN, Tirzepatide, Tirzepatide, Tirzepatide, Tirzepatide, Tirzepatide

Primary endpoint: Change from baseline in Hemoglobin A1c (HbA1c)
Endpoint(s): Change from Baseline in Weight, Percentage of Participants Who Achieve HbA1c <7%, Percentage of Participants Who Achieve HbA1c ≤6.5%, Percentage of Participants Who Achieve HbA1c <5.7%, Percentage of Participants Who Achieve Weight loss from Baseline of ≥5%, Percentage of Participants Who Achieve Weight loss from Baseline of ≥10%, Percentage of Participants Who Achieve Weight loss from Baseline of ≥15%, A Composite Endpoint of HbA1c, Weight loss and Hypoglycemia A composite endpoint defined as HbA1c ≤6.5%, weight loss ≥10%, and no hypoglycemia, defined as blood glucose <54 milligram/deciliter (mg/dL) (<3.0 millimole/liter [mmol/L]) and/or severe hypoglycemia, Change from Baseline in Fasting Serum Glucose, Change from Baseline in Waist Circumference, Change from Baseline in Body Mass Index (BMI), Change from Baseline in Impact of Weight on Quality of Life-Clinical Trials Version (IWQOL-Lite-CT) - Physical Functioning Score

Source: https://euclinicaltrials.eu/ctis-public/view/2022-500101-41-00